EU clinical trial 2025-522252-74-00: Single dose oral bioequivalence study of Cladribine 10 mg Tablets and Mavenclad® 10 mg tablets (Cladribine) in healthy adult human subjects under fed conditions
Protocol code: CPO25001
Sponsor: PharOS Pharmaceutical Oriented Servises Ltd., CCDRD Cooperative Clinical Drug Research and Development AG (Pharmaceutical company). Phase: Human Pharmacology (Phase I)- Bioequivalence Study. Countries: Bulgaria (ended).
Therapeutic area(s): Not possible to specify
Gender: Male. Age: 18-64 years. Enrolment: 40.
Status: Ended. End date (EU): 2026-05-07. Decision date: 2025-10-08. Results received: No. Last updated: 2025-10-08.

Condition(s): No therapeutic indication in the current trial with healthy volunteers.

Source: https://euclinicaltrials.eu/ctis-public/view/2025-522252-74-00